EU clinical trial 2025-523460-21-00: A multicenter, multicohort, phase 2 platform trial to personalize second-line treatment intensity and targeting in HR-positive, HER2-negative metastatic breast cancer through an integrated liquid biopsy algorithm.
Protocol code: interACT
Sponsor: Centro Di Riferimento Oncologico Di Aviano (Hospital/Clinic/Other health care facility). Phase: Therapeutic exploratory (Phase II). Countries: Italy (authorised, recruitment pending).
Therapeutic area(s): Diseases [C] - Neoplasms [C04]
Gender: Female. Age: 18-64 years, 65+ years. Enrolment: 159.
Status: Authorised, recruitment pending. Decision date: 2026-03-31. Results received: No. Last updated: 2026-03-31.

Condition(s): Metastatic breast cancer
Product: Fulvestrant Dr. Reddy’s 250 mg soluzione iniettabile in siringa preriempita, Enhertu 100 mg powder for concentrate for solution for infusion, Capecitabine Teva 150 mg film-coated tablets, TRUQAP 160 mg film-coated tablets, ORSERDU 86 mg film-coated tablets, TRUQAP 200 mg film-coated tablets, ORSERDU 345 mg film-coated tablets, Capecitabine Teva 500 mg film-coated tablets

Primary endpoint: Clinical Benefit Rate (CBR), defined as the proportion of patients achieving a Complete response (CR) or Partial response (PR) or Stable disease (SD) lasting at least 6 months, as assessed according to RECIST 1.1 criteria
Endpoint(s): Progression Free Survival (PFS), defined as time from second line treatment start until progression or death for any cause, whichever comes first, OS, defined as time from second line treatment start until death from any cause, Prevalence of somatic alterations detected through plasma NGS in patients who are candidate to receiving second line therapy in HR+/HER2- MBC, Prognostic impact on PFS and OS of somatic alterations detected through plasma NGS in patients candidate to receiving second line therapy in HR+/HER2- MBC, Proportion of patients with a CTCs count ≥ 5/7.5 mL compared to those with a CTCs count <5/7.5 mL at baseline of second line therapy for HR+/HER2- MBC, Prognostic impact on PFS and OS of a CTCs count ≥ 5/7.5 mL with respect to CTCs count < 5/7.5 mL in patients candidate to receiving second line therapy in HR+/HER2- MBC

Source: https://euclinicaltrials.eu/ctis-public/view/2025-523460-21-00